EU clinical trial 2024-517006-28-00: An open label, multicenter, phase I/II study of belantamab mafodotin in combination with Kd for the treatment of relapsed myeloma patients, refractory to lenalidomide.
Protocol code: GEM-BELMA
Sponsor: Fundacion PETHEMA (Patient organisation/association). Phase: Phase I and Phase II (Integrated)- Other. Countries: Spain (ongoing, recruitment ended).
Therapeutic area(s): Diseases [C] - Hemic and Lymphatic Diseases [C15]
Gender: Female, Male. Age: 18-64 years, 65+ years. Enrolment: 60.
Status: Ongoing, recruitment ended. Start date (EU): 2021-11-23. Decision date: 2024-10-18. Results received: No. Last updated: 2024-10-18.

Condition(s): Multiple myeloma
Product: CARFILZOMIB, BELANTAMAB MAFODOTIN

Primary endpoint: Phase 1: Recommended phase 2 dose (RP2D), Phase 2: Overall Response Rate (ORR), defined as the percentage of participants with a confirmed partial response (PR) or better (PR, VGPR, CR, sCR)., Phase 2: Complete Response Rate (CRR), defined as the percentage of participants with a confirmed complete response (CR) or better (stringent complete response (CR, sCR))., Phase 2: Minimal Residual Disease (MRD) negativity rate, defined as the percentage of participants who are MRD negative by next-generation flow cytometry (NGF). MRD will be evaluated at the time of CR/VGPR, and in all patients at month 12, 18, and 24, and yearly thereafter., Phase 2: Analysis of efficacy endpoints will be based on derived confirmed response according to International Myeloma Working Group (IMWG), Phase 2: Incidence of deaths and primary cause of death., Phase 2: Data for vital signs, Phase 2: Incidence of adverse events (AEs)., Phase 2: Changes in laboratory analyses from the hematology and blood chemistry panel, Phase 2: Ocular findings on ophthalmic exam
Endpoint(s): Duration of Response (DoR), defined as the time from first documented evidence of PR or better until progressive disease (PD) or death due to PD among participants who achieved PR or better, Progression-Free Survival (PFS), defined as the time from the start of treatment until the earliest date of documented disease progression or death due to any cause., Progression-Free Survival at 12 months., Time to Response (TTR), defined as the time from the start of treatment and the first documented evidence of response (PR or better) among participants who achieve confirmed PR or better, Overall Survival (OS), defined as the time from the start of treatment until the date of death due to any cause, Percentage of patients upgrading the response category (i.e. percentage of patients converting from partial response to VGPR, etc.), Percentage of patients achieving minimal residual disease negativity using EuroFlow Panel with a sensitivity of 10-6., Percentage of patients converting from positive MRD to undetectable MRD following EuroFlow panel with a sensitivity of 10-6, Incidence of Treatment related adverse events Percentage of patients discontinuing therapy due to AEs. • Percentage of patients requiring dose modifications.

Source: https://euclinicaltrials.eu/ctis-public/view/2024-517006-28-00